EU clinical trial 2024-515219-23-00: MYELOFLUDATEP: Exploratory study evaluating the value of 18F-Fludarabine PET for the initial or relapsed assessment and therapeutic evaluation of patients with symptomatic multiple myeloma.
Protocol code: RC18_0055
Sponsor: Centre Hospitalier Universitaire De Nantes (Hospital/Clinic/Other health care facility). Phase: Human Pharmacology (Phase I)- Other. Countries: France (ongoing, recruiting).
Therapeutic area(s): Analytical, Diagnostic and Therapeutic Techniques and Equipment [E] - Diagnosis [E01]
Gender: Female, Male. Age: 18-64 years, 65+ years. Enrolment: 35.
Status: Ongoing, recruiting. Start date (EU): 2024-11-08. Decision date: 2024-11-08. Results received: No. Last updated: 2026-07-15.

Condition(s): multiple myeloma

Source: https://euclinicaltrials.eu/ctis-public/view/2024-515219-23-00